EU clinical trial 2025-521769-29-00: A Long-term Open-Label Extension Study of Treprostinil Palmitil Inhalation Powder for Treatment of Pulmonary Hypertension Associated with Interstitial Lung Disease
Protocol code: INS1009-312
Sponsor: Insmed Inc. (Pharmaceutical company). Phase: Therapeutic confirmatory (Phase III). Countries: Greece (authorised, recruitment pending), France (authorised, recruitment pending), Italy (authorised, recruitment pending), Belgium (authorised, recruitment pending), Denmark (authorised, recruitment pending), Germany (authorised, recruitment pending), Poland (authorised, recruitment pending), Czechia (authorised, recruitment pending), Portugal (authorised, recruitment pending), Austria (authorised, recruitment pending), Spain (authorised, recruitment pending), Romania (authorised, recruitment pending).
Therapeutic area(s): Diseases [C] - Respiratory Tract Diseases [C08]
Gender: Female, Male. Age: 18-64 years, 65+ years. Enrolment: 165.
Status: Authorised, recruitment pending. Decision date: 2026-06-30. Results received: No. Last updated: 2026-08-05.
Decision dates by country: PT: 2026-06-30, AT: 2026-07-05, BE: 2026-06-30, DK: 2026-07-01, FR: 2026-07-03, DE: 2026-07-01, GR: 2026-07-02, IT: 2026-07-01, RO: 2026-07-06, ES: 2026-07-06, PL: 2026-07-06, CZ: 2026-08-05

Condition(s): Pulmonary Hypertension Associated with Interstitial Lung Disease
Product: TREPROSTINIL PALMITIL INHALATION POWDER, Placebo (inhalation powder capsules) containing 1 of 4 dosage strengths of TPIP (80 μg, 160 μg, or 320 μg or 640 µg). The placebo product does not contain active substance and is otherwise identical to the IMP, TREPROSTINIL PALMITIL INHALATION POWDER, TREPROSTINIL PALMITIL INHALATION POWDER, TREPROSTINIL PALMITIL INHALATION POWDER

Primary endpoint: AEs, laboratory assessments, vital signs, physical examination, 12-lead ECG, and supplemental oxygen use
Endpoint(s): Change in 6MWD measured post-dose from pre-OLE Baseline up to 104 weeks, Absolute and percent change from pre-OLE Baseline in FVC, FVC% pred, FEV1, and FEV1% pred up to 104 weeks, Change in NT-proBNP plasma concentration from pre-OLE Baseline up to 104 weeks, Annualized rate of ILD exacerbations during the OLE study (104 weeks), Proportion of participants with a clinical worsening event. Clinical worsening events are defined as one of the following: • Hospitalization due to a cardiopulmonary indication related to the disease under study, • Deterioration of PH-ILD, defined as a combination of the following changes from Baseline attributable to the disease under study: − decrease in 6MWD ≥15%, confirmed by 2 tests at least 4 hours but not more than 1 week apart, AND − signs/symptoms of worsened right heart failure or worsened WHO/NYHA functional class. • Lung transplantation (except for when preplanned prior to the study) • Death from any cause, Mean change in L-PF total symptom domain score from pre-OLE Baseline up to 104 weeks Mean change from pre-OLE Baseline up to 104 weeks in: • L-PF cough domain score • L-PF dyspnea domain score • L-PF impact domain score, Mean change from pre-OLE Baseline up to 104 weeks in: • EQ-5D-5L index score • EQ-5D-5L VAS, Proportion of participants with a major morbidity or mortality event, defined as one of the following: • Hospitalization due to a cardiopulmonary indication related to the disease under study • Lung transplantation (except for when pre-planned prior to the study) • Death from any cause

Source: https://euclinicaltrials.eu/ctis-public/view/2025-521769-29-00